EU clinical trial 2024-516767-92-01: A phase 1/2a multicenter trial to evaluate the safety and immunogenicity of the CD40.Pan.CoV vaccine, adjuvanted or not, as a booster in adult participants
Protocol code: ANRS0640s LKV-PAN-01
Sponsor: ANRS Maladies Infectieuses Emergentes (Laboratory/Research/Testing facility). Phase: Human Pharmacology (Phase I)- First administration to humans. Countries: France (ongoing, recruitment ended).
Therapeutic area(s): Diseases [C] - Pathological Conditions, Signs and Symptoms [C23]; Diseases [C] - Virus Diseases [C02]
Gender: Female, Male. Age: 18-64 years. Enrolment: 48.
Status: Ongoing, recruitment ended. Start date (EU): 2025-06-17. Decision date: 2025-04-25. Results received: No. Last updated: 2026-07-30.

Condition(s): Health Participants

Source: https://euclinicaltrials.eu/ctis-public/view/2024-516767-92-01